EU clinical trial 2023-507270-41-00: A Phase II Study of SKB264 as Monotherapy or as Combination Therapy in Subjects with Advanced or Metastatic Non-small Cell Lung Cancer
Protocol code: SKB264-II-04
Sponsor: Sichuan Kelun-Biotech Biopharmaceutical Co. Ltd. (Pharmaceutical company). Phase: Therapeutic exploratory (Phase II). Countries: Spain (ongoing, recruitment ended), Romania (ended).
Therapeutic area(s): Diseases [C] - Neoplasms [C04]
Gender: Female, Male. Age: 18-64 years, 65+ years. Enrolment: 46.
Start date (EU): 2024-11-22. Decision date: 2024-06-07. Results received: No. Last updated: 2026-05-25.
Decision dates by country: ES: 2024-06-07, RO: 2024-06-17

Condition(s): Advanced or Metastatic Non-small Cell Lung Cancer
Product: ROXATIDINE, RANITIDINE, OSIMERTINIB, NIZATIDINE, SKB264, CIMETIDINE, FAMOTIDINE, COMBINATIONS, FAMOTIDINE, CARBOPLATIN, PARACETAMOL, PEMBROLIZUMAB, OSIMERTINIB

Primary endpoint: Dose-limiting toxicity (DLT)Incidence and severity of AEs Discontinuation of study treatment due to AEs, ORR per RECIST v1.1: the proportion of subjects with a confirmed complete response (CR) or partial response (PR)
Endpoint(s): DOR: For subjects with a confirmed CR or PR, DOR is defined as the time from the first documented evidence of CR or PR until radiographic disease progression or death due to any cause, whichever occurs first., PFS: The time from first dose of study intervention to first documentation of radiographic disease progression or death due to any cause, whichever occurs first, OS: The time from first dose of study intervention to death due to any cause., PK parameters including Cmin and Cmax of SKB264-ADC, SKB264-TAB and free KL610023., Anti-drug antibody (ADA) test results of SKB264.

Source: https://euclinicaltrials.eu/ctis-public/view/2023-507270-41-00